EU clinical trial 2023-508602-14-00: A Phase 2, Multicenter, Randomized, Open-label, Active-Control Study of REGN7508, a Factor XI Monoclonal Antibody, for the Prevention of Venous Thromboembolism in Participants Undergoing an Elective, Unilateral, Total Knee Arthroplasty (ROXI-VTE II)
Protocol code: R7508-DVT-2360
Sponsor: Regeneron Pharmaceuticals Inc. (Pharmaceutical company). Phase: Therapeutic exploratory (Phase II). Countries: Bulgaria (ended), Poland (ended), Hungary (ended), Latvia (ended), Lithuania (ended).
Therapeutic area(s): Diseases [C] - Hemic and Lymphatic Diseases [C15]; Diseases [C] - Cardiovascular Diseases [C14]
Gender: Female, Male. Age: 18-64 years, 65+ years. Enrolment: 180.
Status: Ended. Start date (EU): 2024-06-27. End date (EU): 2025-01-08. End date: 2025-01-22. Decision date: 2024-05-31. Results received: Yes. Last updated: 2024-09-30.
Decision dates by country: LT: 2024-05-31, LV: 2024-05-31, HU: 2024-06-03, BG: 2024-06-03, PL: 2024-06-03

Condition(s): Thromboembolic disease
Product: Inhixa 4,000 IU (40 mg)/0.4 mL solution for injection in pre-filled syringe, CLEXANE 4 000 UI (40 mg)/0,4 ml solution injectable en seringue préremplie, REGN7508

Primary endpoint: Incidence of confirmed, adjudicated VTE through day 12
Endpoint(s): Incidence of major bleeding up to approximately day 12, Incidence of clinically relevant non-major (CRNM) bleeding up to approximately day 12, Incidence of treatment emergent adverse events (TEAEs) through end of study; approximately day 75, Incidence of major VTE through day 12, Incidence of Deep venous thrombosis (DVT) at approximately day 12, Concentrations of REGN7508 in serum through end of study; approximately day 75, Change in activated partial thromboplastin time (aPTT) baseline to end of study; approximately day 75, Change in prothrombin time (PT) baseline to end of study; approximately day 75, Incidence of anti-drug antibodies (ADA) to REGN7508 through end of study; approximately day 75, Titer of ADA to REGN7508 through end of study; approximately day 75

Source: https://euclinicaltrials.eu/ctis-public/view/2023-508602-14-00